EU clinical trial 2025-520666-22-00: A Phase 1/2a, Open-label, First-in-Human Study to Evaluate the Safety, Tolerability, Pharmacokinetics, Pharmacodynamics, and Efficacy of BMS-986528 in Participants with Refractory Rheumatoid Arthritis
Protocol code: IM0620001
Sponsor: Bristol-Myers Squibb Services Unlimited Company (Pharmaceutical company). Phase: Phase I and Phase II (Integrated)- First administration to humans. Countries: Poland (authorised, recruitment pending), Italy (authorised, recruitment pending), Spain (authorised, recruitment pending), Germany (authorised, recruiting).
Therapeutic area(s): Diseases [C] - Immune System Diseases [C20]
Gender: Female, Male. Age: 18-64 years. Enrolment: 21.
Start date (EU): 2026-07-31. Decision date: 2026-07-22. Results received: No. Last updated: 2026-07-27.
Decision dates by country: IT: 2026-07-22, DE: 2026-07-22, ES: 2026-07-27, PL: 2026-07-23

Condition(s): Refractory, difficult-to-treat Rheumatoid Arthritis
Product: BMS-986528, TOCILIZUMAB

Primary endpoint: The main goal of this study is to find out if BMS-986528 is safe for people with RA by counting how many people have mild and serious side effects after taking BMS-986528
Endpoint(s): Measure how much BMS-986528 is in the blood at different times after it is given and look at things like the highest amount of BMS-986528 in the blood, how long it takes to reach that amount, and how quickly the body gets rid of it, Measure if BMS-986528 changes the number and types of B cells in the blood, Measure changes in the levels of proteins called immunoglobulins in the blood, Measure if people’s bodies make antibodies against BMS-986528, Check if BMS-986528 helps reduce the symptoms of RA after about 3 months using a score called DAS28-CRP, which measures how much pain and swelling a patient has as well as how much inflammation is in the body and how a patient feels

Source: https://euclinicaltrials.eu/ctis-public/view/2025-520666-22-00